EU clinical trial 2024-512436-29-00: VerifyNow to Optimise Platelet Inhibition in Coronary Acute Syndrome (VERONICA)
Protocol code: EPIC17
Sponsor: Fundacion Epic (Educational Institution). Phase: Phase III and phase IV (Integrated). Countries: Spain (authorised, recruiting).
Therapeutic area(s): Diseases [C] - Cardiovascular Diseases [C14]; Not possible to specify
Gender: Female, Male. Age: 18-64 years, 65+ years. Enrolment: 634.
Status: Authorised, recruiting. Start date (EU): 2026-03-27. Decision date: 2024-04-03. Results received: No. Last updated: 2024-04-03.

Condition(s): CARDIOVASCULAR DISEASES
Product: Brilique 90 mg film-coated tablets, Efient 10 mg film-coated tablets., Plavix 75 mg film-coated tablets

Primary endpoint: Incidence of Net Adverse Cardiac Events (NACE). Net Adverse Cardiac Events, defined as a composite of: death from vascular causes (death from cardiovascular causes or cerebrovascular causes and any death without another known cause), non fatal MI, or non fatal stroke, Bleeding BARC type ≥ 2. At 12 months
Endpoint(s): Incidence of Death (Cardiovascular) at 12 months; Incidence of Death at 12 months; Incidence of Non fatal Myocardial Infarction (MI) at 12 months; Incidence of Stroke at 12 months; Incidence of Thrombosis in target lesion, at 12 months; Incidence of revascularization on target lesion at 12 months; Incidence of (BARC criteria ≥ 2) at 12 months

Source: https://euclinicaltrials.eu/ctis-public/view/2024-512436-29-00